EU clinical trial 2024-517901-97-00: AD ASTRA (Androgen Deprivation with Apalutamide and STereotactic RAdiotherapy)
Protocol code: 56021927PCR2046
Sponsor: Vychodoslovensky Onkologicky Ustav a.s. (Hospital/Clinic/Other health care facility). Phase: Therapeutic exploratory (Phase II). Countries: Slovakia (ongoing, recruitment ended).
Therapeutic area(s): Diseases [C] - Neoplasms [C04]
Gender: Male. Age: 18-64 years, 65+ years. Enrolment: 48.
Status: Ongoing, recruitment ended. Start date (EU): 2023-06-13. Decision date: 2024-10-25. Results received: No. Last updated: 2026-02-19.

Condition(s): Localized or a locally advanced high-risk prostate cancer
Product: JNJ-56021927

Primary endpoint: 5-year biochemical control rate defined as a percentage of surviving patients without biochemical progression after 5 years since the treatment start (assessed by Kaplan-Meier estimate).
Endpoint(s): Major secondary endpoint: Metastasis free survival based on PSMA PET/CT (assessed by Kaplan-Meier estimate)., 5-year biochemical control rate with PSA <0.2 ng/mL., 5-year prostate cancer specific survival., 5-year overall survival (OS). OS is defined as the time from enrollment to date of death from any cause., Incidence of acute and late side effects and complications associated with radiotherapy and systemic treatment evaluated by Common Terminology Criteria of Adverse Event (CTCAE) and Patient Reported Outcomes (PRO) including QoL questionnaires., Effect of the planned interventions on QoL (I-PSS, EPIC-26, FACT-P, EQ-5D-5L, PRO-CTCAE™ (short version)).

Source: https://euclinicaltrials.eu/ctis-public/view/2024-517901-97-00